EU clinical trial 2025-521260-35-00: Early treatment of Atrial fibrillation for Stroke prevention Trial in acute STROKE (EAST-STROKE)
Protocol code: EAST-STROKE
Sponsor: University Medical Center Hamburg-Eppendorf (Hospital/Clinic/Other health care facility). Phase: Therapeutic use (Phase IV). Countries: Spain (authorised, recruitment pending), Germany (ongoing, recruiting), Netherlands (authorised, recruitment pending).
Therapeutic area(s): Diseases [C] - Cardiovascular Diseases [C14]
Gender: Female, Male. Age: 18-64 years, 65+ years. Enrolment: 1035.
Start date (EU): 2025-11-07. Decision date: 2025-09-11. Results received: No. Last updated: 2026-07-07.
Decision dates by country: NL: 2025-09-17, ES: 2025-09-15, DE: 2025-09-11

Condition(s): acute ischemic stroke and atrial fibrillation (AF)
Product: FLECAINIDE ACETATE, AMIODARONE HYDROCHLORIDE, PROPAFENONE HYDROCHLORIDE, DRONEDARONE HYDROCHLORIDE

Primary endpoint: A composite of first recurrent ischaemic stroke, haemorrhagic stroke, unclassified stroke, cardiovascular death, or hospitaliza-tion due to worsening of heart failure or due to acute coronary syndrome (ACS), analysed as time to the first occurrence of one of the aforementioned components.
Endpoint(s): Each of the components of the primary outcome (each analysed as time to first event): recurrent ischemic stroke, haemor-rhagic stroke, unclassified stroke, cardiovascular death, hospitalization due to worsening of heart failure, and hospitalization due to ACS, Recurrent disabling stroke (as time to first event), Recurrent AF (as time to first event), Cardiac rhythm (sinus rhythm vs. AF) at 12 and 24 months, Unplanned cardiovascular hospitalization (as time to first hospitalization), Number of cardiovascular hospitalizations, Change from baseline in left ventricular function (left ventricular ejection fraction [LVEF]) at 24 months, Functional status assessed with the modified Rankin Scale (mRS) at 12 and 24 months, Quality of life assessed with the EuroQol five-dimensional questionnaire (EQ-5D) and Patient-Reported Outcomes Measurement Information System-10 (PROMIS-10) domains on physical and mental health at 12 and 24 months, Cognitive function assessed with the Montreal Cognitive Assessment (MoCA) at 12 and 24 months, Cost of therapy

Source: https://euclinicaltrials.eu/ctis-public/view/2025-521260-35-00